EU clinical trial 2023-509809-76-00: A Randomized, Double-blind, Multicenter Study to Determine the Effect of Triheptanoin Compared with Even-chain, Medium-chain Triglycerides (MCT) on Major Clinical Events (MCEs) in Pediatric Patients with Long-chain Fatty Acid Oxidation Disorders (LC-FAOD)
Protocol code: UX007-CL302
Sponsor: Ultragenyx Pharmaceutical Inc. (Pharmaceutical company). Phase: Therapeutic confirmatory (Phase III). Countries: Spain (ongoing, recruitment ended), Germany (ongoing, recruitment ended), Czechia (ongoing, recruitment ended), Poland (ongoing, recruitment ended).
Therapeutic area(s): Diseases [C] - Nutritional and Metabolic Diseases [C18]
Gender: Female, Male. Age: 0-17 years. Enrolment: 40.
Status: Ongoing, recruitment ended. Start date (EU): 2023-02-28. Decision date: 2024-05-28. Results received: No. Last updated: 2026-02-23.
Decision dates by country: PL: 2024-06-03, DE: 2024-06-13, ES: 2024-05-28, CZ: 2024-05-29

Condition(s): Long-chain Fatty Acid Oxidation Disorders (LC-FAOD)
Product: FAT EMULSIONS, Triheptanoin

Primary endpoint: Annualized event rate of MCEs
Endpoint(s): Annualized duration of MCEs, Annualized hypoglycemic event-rate captured as MCEs and HCEs, CGI-C scale score, Left ventricular ejection fraction, left ventricular systolic volume, and left ventricular wall mass, Annualized frequency and duration of rhabdomyolysis-MCEs, Annualized frequency and duration of cardiomyopathy-MCEs, Annualized duration of hypoglycemic-MCEs, Change from baseline in scores for: Caregiver-reported PedsQL 4.0 Generic Core Scale (physical health summary, psychosocial health summary, and total scores) (2 years of age and older) OR PedsQL Infant Scale (physical health summary, psychosocial health summary, and total scores) (ages 1 to < 24 months), Survival time, Annualized hospitalization days, Number of missed school or learning opportunity days, Frequency, severity, and relationship to study drug of TEAEs, serious TEAEs, and AESIs, Incidence of TEAEs and serious TEAEs leading to dose modifications, dose reductions, treatment interruptions, discontinuations from study drug, and discontinuations from the study, Plasma concentration levels of heptanoate and betahydroxypentanoate (BHP), Acceptability and Palatability Survey scores of triheptanoin mixed with oral liquids, Change from baseline to 6 months in hepatic PDFF%, assessed by 1HMRS in subjects enrolled in the Liver Substudy

Source: https://euclinicaltrials.eu/ctis-public/view/2023-509809-76-00